EU clinical trial 2024-515497-26-00: Aflibercept 8mg for high-frequent Faricimab and prior Aflibercept 2mg treated Neovascular age-related macular degeneration: a monocenter, single-arm, open-label extension study (A-FAN)
Protocol code: A-FAN
Sponsor: Medical University Of Graz (Educational Institution). Phase: Phase III and phase IV (Integrated). Countries: Austria (ended).
Therapeutic area(s): Diseases [C] - Eye Diseases [C11]
Gender: Female, Male. Age: 18-64 years, 65+ years. Enrolment: 33.
Status: Ended. Start date (EU): 2024-10-24. End date (EU): 2025-12-02. Decision date: 2024-09-22. Results received: No. Last updated: 2024-09-22.

Condition(s): Neovascular age-related macular degeneration
Product: AFLIBERCEPT

Primary endpoint: proportion of eyes with at least one extension without retinal (intra- and subretinal) fluid within the time period baseline to 32 weeks (extension success rate)
Endpoint(s): proportion of eyes with maximum extended interval without retinal (intra- and subretinal) fluid of ≥ 6, ≥ 8 and ≥ 10 weeks at 32 weeks, maximum extended treatment interval without retinal (intra- and subretinal) fluid at 32 weeks, number of injections received during 32 weeks, proportion of eyes remaining on a 4-weekly interval from baseline to last visit (completed interval) at 32 weeks, proportion of eyes extended to 6 weeks, without success (intra- and or subretinal fluid present) from baseline to 32 weeks, mean change in ETDRS letter score from baseline to an averaged ETDRS letter score between 24 and 32 weeks, mean averaged ETDRS letter score between 24 and 32 weeks, proportion of eyes gaining ≥ 5 ETDRS letters from baseline to an averaged ETDRS letter score between 24 and 32 weeks, proportion of eyes loosing ≥5 ETDRS letters from baseline to an averaged ETDRS letter score between 24 and 32 weeks, mean change in low-luminance BCVA from baseline over time, mean CST change from baseline (1mm ETDRS grid) to an averaged CST between 24 and 32 weeks, mean CST change from baseline to maximum extended interval without retinal (intra- and subretinal) fluid, proportion of eyes with no intraretinal fluid at baseline and final visit (completed interval) at or before 32 weeks, proportion of eyes with no subretinal fluid at baseline and final visit (completed interval) at or before 32 weeks, proportion of eyes with no retinal (intra- and subretinal) fluid at baseline and final visit (completed interval) at or before 32 weeks, retinal nerve fiber analysis over time, incidence and severity of ocular/non-ocular adverse events, mean change in concentration of plasma VEGF-A over time

Source: https://euclinicaltrials.eu/ctis-public/view/2024-515497-26-00